EU clinical trial 2023-509996-18-00: A Phase 1b, Open-Label, Dose-Escalation Trial of the Safety of and Antigen-Specific Immune Responses Elicited by VB.10 NEO in Combination With Atezolizumab in Subjects with Locally Advanced and Metastatic Tumors
Protocol code: VB N-02
Sponsor: Nykode Therapeutics ASA (Pharmaceutical company). Phase: Human Pharmacology (Phase I)- First administration to humans. Countries: Germany (ended), Spain (ended).
Therapeutic area(s): Diseases [C] - Neoplasms [C04]
Gender: Female, Male. Age: 18-64 years, 65+ years. Enrolment: 40.
Status: Ended. Start date (EU): 2022-01-18. End date (EU): 2024-10-09. End date: 2024-10-10. Decision date: 2024-04-04. Results received: No. Last updated: 2024-07-23.
Decision dates by country: DE: 2024-04-08, ES: 2024-04-04

Condition(s): Locally advanced and metastatic solid tumor including non-small cell lung carcinoma, renal cell carcinoma, urothelial carcinoma, head and neck squamous cell carcinoma, triple-negative breast cancer, gastric/GEJ cancer, cervical, anal, or MSI-high tumors

Source: https://euclinicaltrials.eu/ctis-public/view/2023-509996-18-00